EU clinical trial 2024-510765-42-00: A study in healthy men to learn about how the body absorbs, processes, and removes radioactively labeled BAY 3283142
Protocol code: 22127
Sponsor: Bayer AG (Pharmaceutical company). Phase: Human Pharmacology (Phase I)- Other. Countries: Netherlands (ended).
Therapeutic area(s): Diseases [C] - Cardiovascular Diseases [C14]
Gender: Male. Age: 18-64 years. Enrolment: 8.
Status: Ended. Start date (EU): 2024-10-01. End date (EU): 2024-11-07. Decision date: 2024-07-25. Results received: No. Last updated: 2024-10-02.
Decision dates by country: NL: 2024-09-10

Condition(s): Chronic kidney disease

Source: https://euclinicaltrials.eu/ctis-public/view/2024-510765-42-00